EU clinical trial 2025-522326-13-00: Obesity and Semaglutide in Type 1 Diabetes Therapy (OBES1TY): A Multicentre, Randomised, Double-Blinded, Placebo-Controlled, Investigator-Initiated Trial
Sponsor: Region Hovedstaden (Hospital/Clinic/Other health care facility). Phase: Therapeutic confirmatory (Phase III). Countries: Denmark (authorised, recruiting).
Therapeutic area(s): Diseases [C] - Hormonal diseases [C19]
Gender: Female, Male. Age: 18-64 years, 65+ years. Enrolment: 122.
Status: Authorised, recruiting. Start date (EU): 2026-06-29. Decision date: 2025-09-26. Results received: No. Last updated: 2026-06-12.

Condition(s): Obesity defined by BMI equal to or higher than 30, Obesity defined by BMI equal to or higher than 27 and obesity-related diagnosis registered in the electronic patient journal such as: hypertension, hypercholesterolemia, dyslipidemia, micro albuminuria, ischemic heart disease, stroke, atherosclerosis or athrosis), Type 1 Diabetes
Product: PLACEBO, SEMAGLUTIDE

Primary endpoint: Body weight / BMI
Endpoint(s): Blood pressure, Resting heart rate, Waist circumference, hip-waist ratio, Blood samples - hematology (hemoglobin, leucocytes, thrombocytes), Blood samples - glycemic control (HbA1c, fasting plasma-glucose, fasting c-peptide, ketones), Blood samples - lipids (total, HDL, non-HDL, LDL and VLDL cholesterol, triglycerides), Blood samples - kidney (Sodium, Potassium, creatinine/eGFR, Albumin), Blood samples - liver and gut markers (alanine and aspartate transaminase, fibrosis-4-score, amylase, lipase), Blood samples - inflammatory (high sensitivity C-reactive protein), CGM data - Time in/above/below range (TIR, TAR, TBR), time in tight range (TITR) and coefficient of variation (CV), Total daily dose (TDD) of insulin - selfreported, Insulin sensitivity - measures through golden standard hyperinsulinemic euglycemic clamping (for a subgroup consisting of first 40 patients from two specified sites), Fat percentage - measured through DXA scans (for a subgroup consisting of first 40 patients from two specified sites), Lean mass - measured through DXA scans (for a subgroup consisting of first 40 patients from two specified sites), Bone density (through bone mineral content) - measured through DXA scans (for a subgroup consisting of first 40 patients from two specified sites), Blood samples - Omics and metabolomic profile (lipidome and proteome), Transcriptome - through muscle and fat tissue biopsies, Electrocardiogram (ECG), Dietary patterns - through questionnaire, Diabetes treatment satisfaction - through questionnaire, Diabetes distress - through questionnaire

Source: https://euclinicaltrials.eu/ctis-public/view/2025-522326-13-00